EU clinical trial 2024-513101-31-00: Evaluation of the Hemodynamic Effect of Dexmedetomidine in Scheduled Outpatient Surgery
Protocol code: NIMAO/2022-1/YG01
Sponsor: Centre Hospitalier Universitaire De Nimes (Hospital/Clinic/Other health care facility). Phase: Therapeutic confirmatory (Phase III). Countries: France (ongoing, recruiting).
Therapeutic area(s): Analytical, Diagnostic and Therapeutic Techniques and Equipment [E] - Anesthesia and Analgesia [E03]
Gender: Female, Male. Age: 18-64 years, 65+ years. Enrolment: 594.
Status: Ongoing, recruiting. Start date (EU): 2023-09-11. Decision date: 2024-10-03. Results received: No. Last updated: 2026-02-06.

Condition(s): General anaesthetic for outpatient surgery

Source: https://euclinicaltrials.eu/ctis-public/view/2024-513101-31-00